EU clinical trial 2024-511210-21-00: A parallel-group low-intervention, phase IV, randomized, double-blind, placebo-controlled, single-center, national, two-arm trial to investigate efficacy and safety of Cardiodoron® in patients with functional cardiovascular disorders (FCD)
Protocol code: DR-CR-CAR01S01
Sponsor: Weleda AG (Pharmaceutical company). Phase: Therapeutic use (Phase IV). Countries: Germany (ended).
Therapeutic area(s): Diseases [C] - Cardiovascular Diseases [C14]
Gender: Female, Male. Age: 18-64 years, 65+ years. Enrolment: 125.
Status: Ended. Start date (EU): 2024-07-23. End date (EU): 2026-01-19. Decision date: 2024-07-22. Results received: No. Last updated: 2025-09-23.

Condition(s): functional cardiovascular disorders
Product: Placebo, Cardiodoron® Dilution Wirkstoffe: Ethanol. Digestio aus Onopordum acanthium mit Hyoscyamus niger Ø, Ethanol. Digestio aus Primula veris mit Hyoscyamus niger Ø

Primary endpoint: Baseline adjusted difference in (mean) change from baseline in FCD severity measured by VAS at V3 and V4 (verum compared to placebo), Baseline adjusted difference in (mean) change from baseline in Symptom Score (von Zerssen List B-LR and B-LR’ (sum score of both lists)) at V3 and V4 (verum compared to placebo), Baseline adjusted difference in (mean) change from baseline in (sum) score (GBB-24) at V3 and V4 (verum compared to placebo), Baseline adjusted difference in (mean) change from baseline in quality of life (SF-36; physical health and mental health summary measures) at V3 and V4, Proportion of patients with optimal blood pressure, normotony, high normal blood pressure, hypotension, hypertension (grade 1 3) at V2, V3 and V4, Proportion of patients showing improvements in symptoms (von Zerssen List B-LR and B-LR’ (sum score of both lists)) of 15% or more at treatment end/V4, Proportion of patients who discontinue the trial due to lack of efficacy, Baseline adjusted difference in (mean) change from baseline in Pittsburgh Sleep Quality Index (PSQI) at V3 and V4, Proportion of patients who are very satisfied, satisfied, unsatisfied, very unsatisfied with the efficacy of the IMP, Proportion of patients for whom investigator is very satisfied, satisfied, unsatisfied, very unsatisfied with the efficacy of the IMP, Number, nature (term), causality, severity and seriousness of adverse events, Clinically relevant change in laboratory parameters (blood) at V4 vs. baseline, Proportion of patients who discontinue the trial due to an adverse event, Proportion of patients who are very satisfied, satisfied, unsatisfied, very unsatisfied with the tolerability of the IMP, Proportion of patients for whom investigator is very satisfied, satisfied, unsatisfied, very unsatisfied with the tolerability of the IMP

Source: https://euclinicaltrials.eu/ctis-public/view/2024-511210-21-00